EU clinical trial 2024-515942-18-01: AUSTRAL trial: An open-label, multicenter, phase II study of radiotherapy followed by durvalumab (MEDI4736) and ceralasertib (AZD6738) in stage III NSCLC patients with thoracic relapses +/- oligometastases after PACIFIC regimen
Sponsor: Istituto Di Ricerche Farmacologiche Mario Negri (Laboratory/Research/Testing facility). Phase: Therapeutic exploratory (Phase II). Countries: Italy (ended).
Therapeutic area(s): Diseases [C] - Neoplasms [C04]
Gender: Female, Male. Age: 18-64 years, 65+ years. Enrolment: 17.
Status: Ended. End date (EU): 2026-06-17. Decision date: 2025-07-03. Results received: No. Last updated: 2026-01-22.

Condition(s): Stage III NSCLC patients with loco-regional relapse > 12 months from the end of CRT +/- < 3 metastatic lesions after PACIFIC regimen or PACIFIC-like regimens (concurrent or sequential chemo-radiotherapy followed by maintenance durvalumab), regardless of PD-L1 status, but without EGFR, HER-2 or MET exon14 skipping mutations, ALK, ROS1, RET or NTRK rearrangements.
Product: DURVALUMAB, Ceralasertib

Primary endpoint: To assess the safety and tolerability, in terms of number of grade 3 or higher adverse events judged as at least possibly related to study treatment regimen (radiotherapy followed by systemic therapy with ceralasertib and durvalumab) within 6 months from the start of study treatment., To assess the efficacy in terms of PFS, defined as the time from the date of enrolment until the date of first disease progression or death to any cause, whichever comes first
Endpoint(s): To assess the activity in terms of objective response rate (ORR)., To assess the efficacy in terms of PFS rate at 6 and 12 months, OS, OS rate at 6 and 12 months. OS is defined as the time from enrolment until the date of death from any cause., To assess the safety and tolerability of the treatment.

Source: https://euclinicaltrials.eu/ctis-public/view/2024-515942-18-01